EU clinical trial 2023-505793-15-00: A randomized, double-blind, double dummy, placebo-controlled, four-way cross-over study to investigate the analgesic effects and CNS effects of morphine and fluvoxamine in healthy subjects.
Sponsor: Centre for Human Drug Research (Laboratory/Research/Testing facility). Phase: Human Pharmacology (Phase I)- Other. Countries: Netherlands (ended).
Therapeutic area(s): Diseases [C] - Nervous System Diseases [C10]
Gender: Female, Male. Age: 18-64 years, 65+ years. Enrolment: 24.
Status: Ended. Start date (EU): 2023-10-30. End date (EU): 2024-05-03. Decision date: 2023-10-27. Results received: No. Last updated: 2024-02-29.

Condition(s): Chronic pain

Source: https://euclinicaltrials.eu/ctis-public/view/2023-505793-15-00